EU clinical trial 2024-513854-31-00: Open-label Uncontrolled Trial to Evaluate Pharmacokinetics, Pharmacodynamics, Safety, and Activity of Efgartigimod in Children From 2 to Less Than 18 Years of Age With Generalized Myasthenia Gravis
Protocol code: ARGX-113-2006
Sponsor: Argenx (Pharmaceutical company). Phase: Phase II and Phase III (Integrated). Countries: Germany (authorised, recruiting), Netherlands (ongoing, recruiting), Spain (ongoing, recruiting), France (authorised, recruiting), Poland (ongoing, recruiting), Belgium (ongoing, recruiting), Italy (authorised, recruiting).
Therapeutic area(s): Diseases [C] - Immune System Diseases [C20]
Gender: Female, Male. Age: 0-17 years. Enrolment: 12.
Start date (EU): 2021-10-27. Decision date: 2024-06-24. Results received: No. Last updated: 2026-05-15.
Decision dates by country: ES: 2024-06-24, BE: 2024-06-25, PL: 2024-07-10, DE: 2024-06-26, FR: 2024-06-26, IT: 2024-07-01, NL: 2024-06-25

Condition(s): Generalized Myasthenia Gravis
Product: Vyvgart 20 mg/mL concentrate for solution for infusion

Primary endpoint: Efgartigimod concentrations as input for compartmental, model-driven analysis to determine age and size dependency of clearance and volume of distribution, PD parameters: total IgG levels and anti-acetylcholine receptors antibodies (AChR-Ab) as input for PK/PD modeling analysis
Endpoint(s): Incidence and severity of AEs, incidence of serious AEs (SAEs), incidence of AEs of special interest (AESIs), and changes in laboratory test results, physical examination results, vital sign measurements, and electrocardiogram (ECG) (part B only for ECGs), Efgartigimod serum concentrations, Levels of total IgG and AChR-Ab: absolute values, change from baseline and percent (%) change from baseline, Incidence and prevalence of antidrug antibodies (ADAs) against efgartigimod, MG-ADL total score: absolute value and change from baseline total MG-ADL score, Total QMG score: absolute value and change from baseline, Total score EQ-5D-Y: absolute value and change from baseline, Quality of Life in Neurological Disorders (Neuro-QoL) Pediatric Fatigue Score: values and change from baseline, Change in protective antibody titers to vaccines received before or received during the trial

Source: https://euclinicaltrials.eu/ctis-public/view/2024-513854-31-00